EU clinical trial 2023-509564-22-00: A Phase 2, Single-Arm study of encorafenib plus cetuximab as rechallenge treatment of BRAF V600E-mutant metastatic colorectal cancer patients after previous therapy with BRAF inhibitors-based combinations: the RefIsh trial
Protocol code: VHIO23004
Sponsor: Vall D Hebron Institute Of Oncology (Laboratory/Research/Testing facility). Phase: Therapeutic exploratory (Phase II). Countries: Spain (ongoing, recruiting).
Therapeutic area(s): Diseases [C] - Neoplasms [C04]
Gender: Female, Male. Age: 18-64 years, 65+ years. Enrolment: 25.
Status: Ongoing, recruiting. Start date (EU): 2025-10-30. Decision date: 2025-07-31. Results received: No. Last updated: 2026-02-09.

Condition(s): Patients with BRAF V600E-mutant metastatic colorectal cancer (mCRC) who had received and responded to a BRAF inhibitor-based treatment.
Product: ENCORAFENIB, CETUXIMAB

Primary endpoint: Progression-free survival rate at 4 months (4-month PFS) according to RECIST V1.1 by Investigator assessment.
Endpoint(s): Objective Response Rate (ORR) according to RECIST V1.1 by Investigator assessment., Progression free survival (PFS) according to RECIST V1.1 by Investigator assessment., Overall survival (OS), Clinical efficacy based on the presence absence of acquired genomic mechanism of resistance detected in the NGS baseline to the rechallenge., Incidence and severity of adverse events (AEs), graded by Common Terminology Criteria for Adverse Events (CTCAE) version 5.0., Change in clinical laboratory test parameters, vital signs, ECGs and echocardiogram/MUGA scans.

Source: https://euclinicaltrials.eu/ctis-public/view/2023-509564-22-00